EU clinical trial 2024-512888-31-00: A registry-based, open-label, randomized study to investigate quality-of-life with Plenadren compared with Cortison in participants aged 16-80 with newly diagnosed primary adrenal insufficiency (CORTAD)
Sponsor: Helse Bergen HF (Hospital/Clinic/Other health care facility). Phase: Phase III and phase IV (Integrated). Countries: Norway (ongoing, recruiting).
Therapeutic area(s): Diseases [C] - Hormonal diseases [C19]
Gender: Female, Male. Age: 0-17 years, 18-64 years. Enrolment: 65.
Status: Ongoing, recruiting. Start date (EU): 2023-08-03. Decision date: 2024-08-07. Results received: No. Last updated: 2026-06-09.

Condition(s): Primary adrenal insufficiency (PAI)
Product: Plenadren 20 mg modified-release tablets, Cortison 25 mg tabletter

Primary endpoint: HRQoL score.
Endpoint(s): Blood pressure, body weight, waist circumference, body mass index, cholesterols, glucose, insulin, HOMA index., Hair cortisol level, Salivary cortisol day curves, 24 h urine cortisol and metabolites., Sleep diary, actigraphy, sleep radar., Cognitive testing and biomarker for brain plasticity (BDNF) in serum., Bone mineral density, body composition and bone markers, Adverse events, Serious adverse events, Adrenal crisis symptoms and treatment.

Source: https://euclinicaltrials.eu/ctis-public/view/2024-512888-31-00